EU clinical trial 2023-504022-19-01: A Multicenter, Parallel-group, Double-blind, 2-Arm, Phase III Study to Investigate the Efficacy and Safety of Anifrolumab Administered as Subcutaneous Injection and Added to Standard of Care Compared with Placebo Added to Standard of Care in Adult Participants with Idiopathic Inflammatory Myopathies (Polymyositis and Dermatomyositis)
Protocol code: D3463C00003, JASMINE
Sponsor: AstraZeneca AB (Pharmaceutical company). Phase: Therapeutic confirmatory (Phase III). Countries: Denmark (authorised, recruiting), Belgium (ongoing, recruiting), Italy (ongoing, recruiting), Sweden (authorised, recruiting), Netherlands (authorised, recruiting), Spain (ongoing, recruiting), Austria (ongoing, recruiting), Poland (ongoing, recruiting), Hungary (ongoing, recruiting), Germany (ongoing, recruiting), France (ongoing, recruiting), Czechia (ongoing, recruiting), Bulgaria (ongoing, recruiting).
Therapeutic area(s): Diseases [C] - Immune System Diseases [C20]; Phenomena and Processes [G] - Musculoskeletal and Neural Physiological Phenomena [G11]; Diseases [C] - Musculoskeletal Diseases [C05]; Phenomena and Processes [G] - Immune System Phenomena [G13]; Phenomena and Processes [G] - Immune system processes [G12]
Gender: Female, Male. Age: 18-64 years, 65+ years. Enrolment: 84.
Start date (EU): 2024-12-13. Decision date: 2024-08-13. Results received: No. Last updated: 2026-07-07.
Decision dates by country: FR: 2024-08-14, ES: 2024-08-13, BE: 2024-08-13, BG: 2024-08-16, HU: 2024-08-16, CZ: 2024-08-15, IT: 2024-08-14, PL: 2024-08-13, DE: 2024-08-19, AT: 2024-08-19, DK: 2024-08-13, NL: 2024-08-15, SE: 2024-08-15

Condition(s): Polymyositis or dermatomyositis according to 2017 EULAR / ACR classification criteria
Product: Anifrolumab, Anifrolumab Placebo

Primary endpoint: Participants who have at least moderate improvement in disease activity (TIS ≥ 40) and has not met “confirmed deterioration” criteria at 2 consecutive visits
Endpoint(s): MMT-8 (CSM) change from baseline at week 52, Participants who achieve oral corticosteroid dose ≤ 7.5 mg/day at week 52 (yes/no), PM Participants who have at least moderate improvement in disease activity (TIS ≥ 40) at week 52 and has not met “confirmed deterioration” criteria at 2 consecutive visits up to and including week 52, DM Participants who have at least moderate improvement in disease activity (TIS ≥ 40) at week 52 and has not met “confirmed deterioration” criteria at 2 consecutive visits up to and including week 52, CDASI-activity change from baseline (DM participants only) at week 8, "MMT-8 (CSM) change from baseline at Week 52. Only PM participants will be included in the analysis.", "MMT-8 (CSM) change from baseline at Week 52 Only DM participants will be included in the analysis.", "Participants who achieve OCS dose ≤ 7.5 mg/day at Week 52 (yes/no). Only PM participants with baseline OCS dose > 7.5 mg/day at baseline will be included in the analysis.", "Participants who achieve OCS dose ≤ 7.5 mg/day at Week 52 (yes/no). Only DM participants with baseline OCS dose > 7.5 mg/day at baseline will be included in the analysis."

Source: https://euclinicaltrials.eu/ctis-public/view/2023-504022-19-01